EU clinical trial 2023-507482-26-00: PEACE 8: Combination of darolutamide and stereotactic body radiation therapy in patients with castration resistant prostate cancer and oligometastases on functional imaging.
Protocol code: UC-GTG-2306
Sponsor: Unicancer (Hospital/Clinic/Other health care facility). Phase: Therapeutic confirmatory (Phase III). Countries: France (ongoing, recruiting), Belgium (authorised, recruitment pending), Ireland (authorised, recruitment pending), Spain (authorised, recruitment pending).
Therapeutic area(s): Diseases [C] - Neoplasms [C04]
Gender: Male. Age: 18-64 years, 65+ years. Enrolment: 287.
Start date (EU): 2024-10-04. Decision date: 2024-06-03. Results received: No. Last updated: 2026-05-29.
Decision dates by country: FR: 2024-06-03, BE: 2025-03-31, IE: 2025-04-17, ES: 2025-04-16

Condition(s): Castrate-resistant prostate cancer with oligometastases on functional imaging (PSMA or choline/fluciclovine-positron-emission tomography).
Product: TRIPTORELIN, BAY 1841788, LEUPRORELIN ACETATE, GOSERELIN, NUBEQA 300 mg film-coated tablets, DEGARELIX

Primary endpoint: The superiority of stereotactic body radiation therapy combined with darolutamide to darolutamide alone for patients with CRPC having 1 to 5 oligometastases will be assessed using radiographic progression-free survival (rPFS).
Endpoint(s): Safety/tolerance will be assessed according to the incidence of AEs (graded using the NCI CTCAE v5.0)., Efficacy will be assessed using the Overall survival (OS), Time to treatment failure (TTF), Prostate cancer-specific survival, Time to PSA progression, Biochemical response rate, Time to next symptomatic skeletal event (SSE), Time to pain progression and Quality of life.

Source: https://euclinicaltrials.eu/ctis-public/view/2023-507482-26-00